EU clinical trial 2023-506699-29-00: A Study to Evaluate the Safety, Tolerability, Pharmacokinetics, and Efficacy of RO7443904 in Combination with Glofitamab in Participants with Relapsed/Refractory B-Cell Non-Hodgkin’s Lymphoma
Protocol code: BP43131
Sponsor: F. Hoffmann-La Roche AG (Pharmaceutical company). Phase: Human Pharmacology (Phase I)- Other. Countries: Denmark (ended), France (ended), Italy (ended).
Therapeutic area(s): Diseases [C] - Neoplasms [C04]
Gender: Female, Male. Age: 18-64 years, 65+ years. Enrolment: 55.
Status: Ended. Start date (EU): 2022-03-03. End date (EU): 2024-08-01. End date: 2024-08-02. Decision date: 2024-01-29. Results received: No. Last updated: 2024-02-26.
Decision dates by country: DK: 2024-01-29, FR: 2024-01-30, IT: 2024-02-26

Condition(s): Relapsed/Refractory B-Cell Non-Hodgkin’s Lymphoma (r/r NHL)

Source: https://euclinicaltrials.eu/ctis-public/view/2023-506699-29-00